EU clinical trial 2024-514549-12-00: The use of therapeutic monitoring of ocrelizumab serum concentrations for personalized pharmacotherapy of relapsing-remitting and primary progressive multiple sclerosis
Protocol code: FNO-RS2-OCREPRIPRO
Sponsor: Fakultni Nemocnice Ostrava (Hospital/Clinic/Other health care facility). Phase: Therapeutic use (Phase IV). Countries: Czechia (ongoing, recruiting).
Therapeutic area(s): Diseases [C] - Nervous System Diseases [C10]
Gender: Female, Male. Age: 18-64 years, 65+ years. Enrolment: 100.
Status: Ongoing, recruiting. Start date (EU): 2025-06-16. Decision date: 2024-09-10. Results received: No. Last updated: 2025-09-05.

Condition(s): Multiple Sclerosis
Product: Ocrevus 920 mg solution for injection, Ocrevus 300 mg concentrate for solution for infusion

Primary endpoint: To determine serum concentrations of neurofilament light chains (ng/L), To determine serum concentrations of glial fibrillary acidic protein (ng/L), To determine the presence of antibodies against OCR (mg/L), To determine the number of CD19+ cells (or other cells of the immune system that are associated with MS), To determine the quality of life measured with the MSQOL-54 questionnaire (point value score), To assess clinical status using the 25FWT, 9HPT and SDMT tests (point value score), To assess the results of brain magnetic resonance examination (number of new or recently enlarged T2 lesions or T1 Gd+ lesions, average percentage change in brain volume), To determine disability progression (assessed as change on the EDSS scale), To determine the course of MS (assessed as NEDA-3 concept), To determine occurrence of relapses since the previous check-up (for patients with relapsing remitting MS)
Endpoint(s): To determine serum concentrations of OCR in patients with RR and/or PP RS – observational goal, To determine whether the dose of OCR or the serum concentration of OCR better correlates with the development of paraclinical and clinical parameters and with the prognosis of patients with RR and/or PP MS - observational goal, To analyze the correlation of possible adverse effects of OCR with its measured serum concentration; evaluated variables: OCR adverse effects (infectious and other), blood count, serum creatinine concentration (µmol/L), eGFR (ml/s), serum concentration of IgG (g/L) and IgM (g/L) – safety target, On the basis of the obtained data, possibly introduce TDM OCR into routine clinical practice in patients with RR and/or PP MS and thus expand the multidisciplinary approach to patients with this diagnosis – implementation goal

Source: https://euclinicaltrials.eu/ctis-public/view/2024-514549-12-00